EU clinical trial 2023-510421-14-00: Prospective Study of Added Value of Florastamin (18F) PET/CT in Localisation of Clinically Significant Prostate Cancer in Patients with PI- Report of Multi-Parametric MRI, Elevated Serum PSA Levels and/or PSA Density and with Clinical Suspicion of Prostate Cancer
Protocol code: IASON FC303
Sponsor: Curium Austria GmbH (Pharmaceutical company). Phase: Therapeutic confirmatory (Phase III). Countries: Austria (ended).
Therapeutic area(s): Analytical, Diagnostic and Therapeutic Techniques and Equipment [E] - Diagnosis [E01]
Gender: Male. Age: 18-64 years, 65+ years. Enrolment: 71.
Status: Ended. End date (EU): 2025-09-03. Decision date: 2024-08-12. Results received: No. Last updated: 2024-08-12.

Condition(s): Prostate cancer
Product: Prostavue

Primary endpoint: Localisation of csPCa in patients with elevated serum PSA levels and/or PSA density and clinical suspicion of PCa. Percentage of true positive (TP) patients among TP divided by (TP + false negative (FN)).
Endpoint(s): Percentage of true negative (TN) patients among TN divided by (TN + false positive (FP))., Percentage of true positive (TP) sites among TP divided by (TP + false negative (FN))., NRI of florastamin (18F)., Percentage of patients in whom the initially scheduled diagnostic thinking has been modified based on florastamin (18F) PET/CT results., Percentage of patients in whom the therapeutic management of PCa has been modified based on florastamin (18F) PET/CT results., Correlation of patient based diagnostic performance of florastamin (18F) PET/CT with PHI when available., Quantitative uptake of florastamin (18F) by csPCa, Percentage adverse events observed during the first 24 hours florastamin (18F) administration., Correlation of quantitative uptake of florastamin (18F) with histopathological results., Establishment of interpretation criteria.

Source: https://euclinicaltrials.eu/ctis-public/view/2023-510421-14-00